EU clinical trial 2024-512826-26-00: Impact of neoadjuvant immunotherapy in early stage breast cancer before standard therapy (BIS-Program)
Protocol code: 2020-004696-41
Sponsor: Institut Gustave Roussy (Hospital/Clinic/Other health care facility). Phase: Therapeutic exploratory (Phase II). Countries: France (ended).
Therapeutic area(s): Diseases [C] - Neoplasms [C04]
Gender: Female, Male. Age: 18-64 years, 65+ years. Enrolment: 185.
Status: Ended. Start date (EU): 2022-03-07. End date (EU): 2024-12-17. Decision date: 2024-09-25. Results received: No. Last updated: 2024-09-25.

Condition(s): Newly diagnosed, non-metastatic early-stage triple-negative or HER2+ breast cancer
Product: Perjeta 420 mg concentrate for solution for infusion, Herceptin 150 mg powder for concentrate for solution for infusion, Avastin 25 mg/ml concentrate for solution for infusion., Tecentriq 840 mg concentrate for solution for infusion

Primary endpoint: Presence/ of two-fold increase in GzmB+ CD8+ T cell levels from baseline to post-treatment window in biopsies.
Endpoint(s): Changes in CD8+, PD-L1, MHC-I and % of Ki67 expression from baseline (pre-study) to end of study-treatment biopsies, Changes from baseline tumor tissue to end of treatment in immune infiltrates, immune-related gene expression, Incidence, nature and severity of Adverse Events graded according to NCI-CTCAE v5.0 collected during treatment and up to 4 weeks post-surgery, Clinical response after experimental therapy, defined as a > 30% decrease in tumor diameter from baseline breast ultrasound based on investigator assessment, pCR defined as the absence of any residual invasive cancer based on histological evaluation of the resected specimen during definitive breast cancer surgery, Rate of anti-Pembrolizumab antibodies at day 1 of cycle 2 Pembrolizumab (only patients in TNBC cohort, who will have Pembrolizumab as neoadjuvant systemic treatment).

Source: https://euclinicaltrials.eu/ctis-public/view/2024-512826-26-00